EU clinical trial 2024-515888-54-00: A Randomised, double-blinded, placebo-controlled, multicenter study of efficacy, safety and side effects of highly diluted atropine collyrium in slowing the progression of myopia (shortsightedness) in children
Protocol code: MARS_2020
Sponsor: Fakultni Nemocnice Brno (Hospital/Clinic/Other health care facility). Phase: Therapeutic confirmatory (Phase III). Countries: Czechia (ongoing, recruitment ended).
Therapeutic area(s): Diseases [C] - Eye Diseases [C11]
Gender: Female, Male. Age: 0-17 years. Enrolment: 237.
Status: Ongoing, recruitment ended. Start date (EU): 2022-06-29. Decision date: 2024-11-01. Results received: No. Last updated: 2026-04-02.

Condition(s): Myopia in children
Product: Placebo collyrium, Atropini collyrium 0.04%, Atropini collyrium 0.02%

Primary endpoint: The primary objective of the clinical trial is to determine the difference in axial eye length (AXL) over a 12M application period with 0,02% atropine versus placebo.
Endpoint(s): Difference of AXL over 12M administration period with 0,04% atropine versus placebo, Difference of AXL over 12M administration period with 0,02% atropine versus 0,04%, Difference in AXL over 24M administration period with 0,02% and 0,04% atropine versus placebo and mutually, Rebound phenomenon in both active arms (0,02% and 0,04%) in the period 24M - 36M against placebo and mutually, Cycloplaegic spherical equivalent refraction (SER) difference for 12M administration period (0,02% and 0,04% versus placebo and mutually), Cyloplaegic SER difference for 24M administration period (0,02% and 0,04% versus placebo and mutually), Difference AXL / CR index for 12M administration period (0,02% and 0,04% against placebo and mutually), Difference of AXL / CR index for 24M administration period (0,02% and 0,04% against placebo and mutually), Visual functional characteristics (BCDVA - best corrected distance visual acuity; BCNVA - best corrected near visual acuity; contrast sensitivity; colour perception), Other growth characteristics of the eye (anterior segment biometry: corneal topography and keratometry, anterior chamber, lens thickness, horizontal anterior chamber dimension (WTW); choroidal thickness), Functional characteristics of the eye (NPA - near-point of accommodation; NPC - near point of convergence; facility of accommodation)), SE peripheral defocus, Influence of genetic predisposition (parental refractive error, body height and BMI), Influence of lifestyle (living outside, close work including technologies), The intensity, severity and frequency of all side effects - Systemic (heart rate and other reported adverse events) - Ophthalmological TRAE - Subjects' visual comfort - Retinal vascular change,RNFL - retinal layers of nerve fibers, intraocular pressure, iris colour - Static photoreaction (photopic and [scotopic] mesopic pupil diameter) - NPA, NPC and facility of accommodation - Corneal and conjunctival irritation (Oxford fluorescein test), Compliance stated by the patient (or parents, legal representative), Quality of life and discomfort associated with therapy: self-assessment of younger patients, Impact of atropine therapy on quality of life (ATI Pediatric Eye Disease Investigator Group [PEDIG]) assessed by patient and parents / legal guardian

Source: https://euclinicaltrials.eu/ctis-public/view/2024-515888-54-00